EU clinical trial 2025-521322-14-00: FILO-AML-01-MIVONU A single arm phase II study investigating the efficacy and safety of the addition of ivosidenib to oral azacitidine (Onureg®) in patients over 55 with Acute Myeloid Leukemia (AML) and IDH1 mutation, in complete remission after intensive chemotherapy. A study of the French AML Intergroup.
Protocol code: FILO-AML-01-MIVONU
Sponsor: French Innovative Leukemia Organization (Laboratory/Research/Testing facility). Phase: Therapeutic exploratory (Phase II). Countries: France (authorised, recruitment pending).
Therapeutic area(s): Diseases [C] - Hemic and Lymphatic Diseases [C15]
Gender: Female, Male. Age: 18-64 years, 65+ years. Enrolment: 60.
Status: Authorised, recruitment pending. Decision date: 2025-11-17. Results received: No. Last updated: 2026-04-01.

Condition(s): Patients over 55 with Acute Myeloid Leukemia (AML) and IDH1 mutation, in complete remission after intensive chemotherapy.
Product: Tibsovo 250 mg film-coated tablets, Onureg 200 mg film coated tablets, Onureg 300 mg film coated tablets

Primary endpoint: Relapse-free-survival (RFS) at 24 months in patients receiving oral azacitidine with ivosidenib.
Endpoint(s): RFS at 12 months, with the same definition for RFS as for the primary endpoint., Overall survival defined as the time between inclusion assignment and death from any cause, at 12 and 24 months. Patients alive will be censored at the date of last news, or data cutoff., EFS MRD-, defined in patients who were MRD negative at baseline as the time from inclusion to MRD relapse (by FCM or RT-qPC for NPM1) or death from any cause, whichever occurred first. Patients alive without MRD relapse will be censored at the date of last MRD assessment., Number of participants with Treatment Emergent Adverse Events (TEAEs), according the CTCAE v5.0 classification.

Source: https://euclinicaltrials.eu/ctis-public/view/2025-521322-14-00